EU clinical trial 2024-511469-13-00: A Phase 2 study to assess the efficacy and safety of 2 dosage regimens of oral fidrisertib (IPN60130) for the treatment of fibrodysplasia ossificans progressiva in male and female paediatric and adult participants.
Protocol code: D-CA-60130-452
Sponsor: Clementia Pharmaceuticals Inc. An Ipsen Company (Pharmaceutical company). Phase: Therapeutic exploratory (Phase II). Countries: Sweden (ended), Germany (ended), France (ended), Netherlands (ended), Spain (ended), Belgium (ended), Italy (ended), Portugal (ended).
Therapeutic area(s): Diseases [C] - Congenital, Hereditary, and Neonatal Diseases and Abnormalities [C16]
Gender: Female, Male. Age: 0-17 years, 18-64 years, 65+ years. Enrolment: 34.
Status: Ended. Start date (EU): 2021-10-19. End date (EU): 2026-03-24. Decision date: 2024-04-26. Results received: No. Last updated: 2026-06-12.
Decision dates by country: DE: 2024-04-29, PT: 2024-04-29, NL: 2024-04-26, SE: 2024-04-26, FR: 2024-04-30, ES: 2024-04-29, IT: 2024-05-08, BE: 2024-04-26

Condition(s): Fibrodysplasia Ossificans Progressiva
Product: Placebo capsule

Primary endpoint: The annualized change from baseline in HO volume as assessed by low-dose WBCT (excluding the head) in treated participants receiving IPN60130 through M12 compared with placebo., Adverse events / serious adverse events (AEs/SAE), outcomes, vital signs, physical examinations, body weight and height, laboratory parameters, serum or urine pregnancy tests for females of childbearing potential (FOCBP), concomitant medications.
Endpoint(s): Change from baseline in HO volume of new HO lesions as detected by WBCT in participants receiving IPN60130 compared with placebo recipient at M12., Change from baseline in number of HO lesions by WBCT in participants receiving IPN60130 compared with placebo recipients at M12, Rate of flare-up (as confirmed by Investigator evaluation) and number of flare-up days in participants receiving INP60130 compared with placebo at M12., The number of body regions with new HO in participants treated with IPN60130 compared with placebo recipients at M12., Change from baseline in pain intensity over time assessed using the NRS in participants ≥13 years of age and the Wong Baker FPS in participants <13 years of age for participants receiving IPN60130 compared with placebo recipients through M12., The proportion of participants with any new HO in participants receiving IPN60130 compared with placebo recipients through M12., Change from baseline in HO volume as detected by WBCT in participants receiving IPN60130 compared with placebo recipients and with participants receiving the standard of care in the Natural History Study (NHS) in all available timepoints, Change from baseline in CAJIS by treatment arm compared with placebo recipients and participants receiving the standard of care in the NHS across all available timepoints., Change from baseline in the FOP-PFQ by treatment arm compared with placebo recipients and participants receiving the standard of care in the NHS across all available timepoints., Pharmacokinetic: Pharmacokinetic parameters by population PK modelling using all sparse samples collected during the study., Exposure-Response: Exposure-response analysis by modelling using relevant efficacy and safety parameters

Source: https://euclinicaltrials.eu/ctis-public/view/2024-511469-13-00